EU clinical trial 2025-523094-42-00: Effects of butyrate enemas on postoperative intestinal motility disorders in Hirschsprung’s disease
Protocol code: RCAPHM18_0018
Sponsor: Assistance Publique Hopitaux De Marseille (Hospital/Clinic/Other health care facility). Phase: Therapeutic confirmatory (Phase III). Countries: France (authorised, recruitment pending).
Therapeutic area(s): Diseases [C] - Congenital, Hereditary, and Neonatal Diseases and Abnormalities [C16]
Gender: Female, Male. Age: 0-17 years. Enrolment: 58.
Status: Authorised, recruitment pending. Decision date: 2025-12-16. Results received: No. Last updated: 2025-12-16.

Condition(s): Hirschsprung's disease
Product: Sodium butyrate 1,1 g/L sol prep

Primary endpoint: Time to recovery of bowel function after the curative surgery
Endpoint(s): Assessmenof postoperative functional intestinal obstructive symptoms, Stool consistency evaluated using the validated ‘Bristol’ stool form scale modified for children, Red carmine total intestinal transit time measured, HAEC episode(s) defined by the HAEC score (Pastor et al., 2009; Frykman et al., 2017) and grading of HAEC (Gosain et al, 2017)., Fecal calprotectin measurement

Source: https://euclinicaltrials.eu/ctis-public/view/2025-523094-42-00